EU clinical trial 2023-509889-38-00: A study in healthy people to test how BI 1015550 is taken up in the body when given with or without food
Protocol code: 1305-0039
Sponsor: Boehringer Ingelheim International GmbH (Pharmaceutical company). Phase: Human Pharmacology (Phase I)- Other. Countries: Germany (ended).
Therapeutic area(s): Not possible to specify
Gender: Female, Male. Age: 18-64 years. Enrolment: 18.
Status: Ended. Start date (EU): 2024-05-28. End date (EU): 2024-07-24. Decision date: 2024-04-17. Results received: No. Last updated: 2024-07-26.

Condition(s): Healthy volunteer trial

Source: https://euclinicaltrials.eu/ctis-public/view/2023-509889-38-00